EU clinical trial 2023-504820-24-00: A Phase III, Randomized, Double-blind Trial of Platinum Doublet Chemotherapy +/- Pembrolizumab (MK-3475) as Neoadjuvant/Adjuvant Therapy for Participants with Resectable Stage II, IIIA, and Resectable IIIB (T3-4N2) Non-small Cell Lung Cancer (NSCLC) (KEYNOTE-671)
Protocol code: MK-3475-671
Sponsor: Merck Sharp & Dohme LLC (Pharmaceutical company). Phase: Therapeutic confirmatory (Phase III). Countries: Estonia (ongoing, recruitment ended), Lithuania (ongoing, recruitment ended), France (ongoing, recruitment ended), Ireland (ongoing, recruitment ended), Germany (ongoing, recruitment ended), Belgium (ongoing, recruitment ended), Latvia (ongoing, recruitment ended), Italy (ongoing, recruitment ended), Spain (ongoing, recruitment ended), Romania (ongoing, recruitment ended), Poland (ongoing, recruitment ended).
Therapeutic area(s): Diseases [C] - Neoplasms [C04]
Gender: Female, Male. Age: 18-64 years, 65+ years. Enrolment: 275.
Status: Ongoing, recruitment ended. Start date (EU): 2018-03-21. Decision date: 2023-10-06. Results received: No. Last updated: 2026-02-09.
Decision dates by country: LV: 2023-10-09, BE: 2023-10-06, EE: 2023-10-10, LT: 2023-10-19, IE: 2023-10-06, IT: 2023-10-10, FR: 2023-10-06, RO: 2023-10-20, PL: 2023-10-30, DE: 2023-10-11, ES: 2023-10-11

Condition(s): Neoadjuvant/Adjuvant treatment for participants with Resectable Stage II or IIIA-B (N2) NSCLC
Product: Placebo (Normal saline), KEYTRUDA 25 mg/mL concentrate for solution for infusion, CISPLATIN, PEMETREXED, GEMCITABINE

Primary endpoint: Event Free Survival (EFS), Overall Survival (OS)
Endpoint(s): Major Pathological Response (mPR) Rate, Pathological Complete Response (pCR) Rate, Global Health Status/Quality of Life (GHS/QoL) Score using the European Organization for Research and Treatment (EORTC) QoL Questionnaire (QLQ-C30), Adverse Events (AEs), Perioperative Complications, Treatment Discontinuations Due to AEs

Source: https://euclinicaltrials.eu/ctis-public/view/2023-504820-24-00